EU clinical trial 2025-520766-22-00: A Global Phase 3 Open-Label Extension Study to Assess the Long-Term Safety, Tolerability, and Efficacy of Intravenous AOC 1001 for the Treatment of Myotonic Dystrophy Type 1
Protocol code: AOC 1001-CS4
Sponsor: Avidity Biosciences Inc. (Pharmaceutical company). Phase: Therapeutic confirmatory (Phase III). Countries: France (ongoing, recruiting), Denmark (ongoing, recruiting), Spain (ongoing, recruiting), Italy (ongoing, recruiting), Germany (ongoing, recruiting), Netherlands (ongoing, recruiting).
Therapeutic area(s): Diseases [C] - Musculoskeletal Diseases [C05]
Gender: Female, Male. Age: 0-17 years, 18-64 years. Enrolment: 46.
Status: Ongoing, recruiting. Start date (EU): 2026-01-21. Decision date: 2025-09-29. Results received: No. Last updated: 2026-08-07.
Decision dates by country: FR: 2025-10-02, DE: 2025-10-06, ES: 2025-09-30, NL: 2025-10-01, IT: 2025-10-02, DK: 2025-09-29

Condition(s): Myotonic Dystrophy Type 1
Product: AOC 1001

Primary endpoint: 1. Incidence of TEAEs

Source: https://euclinicaltrials.eu/ctis-public/view/2025-520766-22-00